EU clinical trial 2025-522056-10-01: A Prospective, Multicenter, Open-label, Phase 3 Clinical Study to Evaluate the Efficacy and Safety of Prophylactic VGA039 in Adolescent and Adult Patients with von Willebrand Disease (VIVID-6)
Protocol code: VGA039-CP002
Sponsor: Vega Therapeutics Inc. (Pharmaceutical company). Phase: Therapeutic confirmatory (Phase III). Countries: Austria (ongoing, recruiting), Italy (authorised, recruiting), Ireland (authorised, recruiting), Germany (ongoing, recruiting), Finland (authorised, recruitment pending).
Therapeutic area(s): Diseases [C] - Hemic and Lymphatic Diseases [C15]
Gender: Female, Male. Age: 18-64 years, 65+ years. Enrolment: 16.
Start date (EU): 2026-03-19. Decision date: 2025-12-08. Results received: No. Last updated: 2026-08-07.
Decision dates by country: DE: 2026-01-26, AT: 2025-12-08, IE: 2026-01-26, IT: 2026-01-26, FI: 2026-04-08

Condition(s): von Willebrand Disease
Product: VGA039

Primary endpoint: Annualized bleeding rate (ABR)

Source: https://euclinicaltrials.eu/ctis-public/view/2025-522056-10-01